EU clinical trial 2023-509434-19-00: Multicenter, Open-Label, Randomized Study of Nipocalimab or IVIG in Pregnancies At Risk of Fetal and Neonatal Alloimmune Thrombocytopenia (FNAIT)
Protocol code: 80202135FNAIT3003
Sponsor: Janssen Cilag International (Pharmaceutical company). Phase: Therapeutic confirmatory (Phase III). Countries: Germany (ongoing, recruiting), Austria (authorised, recruitment pending), Poland (ongoing, recruiting), Netherlands (authorised, recruitment pending), Hungary (authorised, recruitment pending).
Therapeutic area(s): Diseases [C] - Immune System Diseases [C20]
Gender: Female. Age: 18-64 years. Enrolment: 14.
Start date (EU): 2025-02-10. Decision date: 2024-12-10. Results received: No. Last updated: 2026-07-20.
Decision dates by country: AT: 2024-12-12, PL: 2024-12-16, NL: 2025-09-29, HU: 2026-07-20, DE: 2024-12-10

Condition(s): Fetal and Neonatal Alloimmune Thrombocytopenia (FNAIT)
Product: PREDNISONE, Imaavy 185 mg/mL concentrate for solution for infusion, IMMUNOGLOBULINS, NORMAL HUMAN, FOR INTRAVASCULAR ADM., PREDNISONE

Primary endpoint: Adverse outcome of death or adjudicated severe bleeding in utero, and up to the first week post birth, or platelet count at birth <30×10^9/L in a fetus/neonate

Source: https://euclinicaltrials.eu/ctis-public/view/2023-509434-19-00